EU clinical trial 2023-508587-29-00: A Pivotal Phase 2 Trial of Antibody Naxitamab (hu3F8) and Granulocyte-Macrophage Colony Stimulating Factor (GM-CSF) in High-Risk Neuroblastoma Patients with Primary Refractory Disease or Incomplete Response to Salvage Treatment in Bone and/or Bone Marrow
Protocol code: 201
Sponsor: Y-mAbs Therapeutics A/S (Pharmaceutical company). Phase: Therapeutic exploratory (Phase II). Countries: Denmark (ongoing, recruitment ended), France (ended), Germany (ongoing, recruitment ended), Spain (ongoing, recruitment ended), Italy (ongoing, recruitment ended).
Therapeutic area(s): Diseases [C] - Neoplasms [C04]
Gender: Female, Male. Age: 0-17 years, 18-64 years. Enrolment: 81.
Start date (EU): 2018-04-03. Decision date: 2023-12-07. Results received: No. Last updated: 2026-06-23.
Decision dates by country: FR: 2023-12-08, ES: 2023-12-11, DK: 2023-12-07, DE: 2023-12-08, IT: 2024-06-11

Condition(s): Treatment of high-risk neuroblastoma patients with primary refractory disease or incomplete response to salvage treatment in bone and/or bone marrow
Product: Humanized IgG1 monoclonal antibody against GD2, Leukine

Primary endpoint: Objective Response Rate (ORR) during the naxitamab treatment period, centrally assessed according to the International Neuroblastoma Response Criteria (INRC)
Endpoint(s): Safety will be evaluated by the incidence of adverse events (AEs) and serious adverse events (SAEs) graded according to Common Terminology Criteria for Adverse Events (CTCAE), version 4.0, DoR, defined as the time from first objective response (CR or partial response (PR)) to PD; data will be censored at the date of last disease evaluation before new anti-NB treatment, Complete response rate, during the naxitamab treatment period, centrally assessed according to the INRC, ORR, during the naxitamab treatment period, investigator assessed according to International Neuroblastoma Response Criteria (INRC), Assessment of the PK of naxitamab, Assessment of ADA formation, Intravenous (IV) opioid use during cycle 1 defined as total dosage of IV morphine (or equivalent opioid) administered 2 hours before infusion until 4 hours after end of infusion of naxitamab, Intravenous (IV) opioid use for each cycle during the trial defined as total dosage of IV morphine (or equivalent opioid) administered 2 hours before infusion until 4 hours after end of infusion of naxitamab, Number of hospitalization days related to naxitamab during cycle 1, defined as number of overnight stays. Hospitalizations required solely for protocol-specified assessments (e.g., PK sampling) or non-medical circumstances are excluded, Number and percentage of infusions done in an outpatient setting, In patients with positive ADA at trial inclusion, safety will be evaluated by the incidence of AEs and SAEs graded according to CTCAE, version 4.0, Happiness and activity levels measured over time assessed by caretaker, Pain during naxitamab infusion as assessed by Wong Baker- and FLACC scales

Source: https://euclinicaltrials.eu/ctis-public/view/2023-508587-29-00